EU clinical trial 2023-505637-27-00: A Long-Term Extension Study of Nusinersen (BIIB058) Administered at Higher Doses in Participants With Spinal Muscular Atrophy Who Previously Participated in an Investigational Study With Nusinersen - ONWARD
Protocol code: 232SM302
Sponsor: Biogen Idec Research Limited (Pharmaceutical company). Phase: Therapeutic confirmatory (Phase III). Countries: Italy (ended), Spain (ongoing, recruitment ended), Germany (ended).
Therapeutic area(s): Diseases [C] - Musculoskeletal Diseases [C05]
Gender: Female, Male. Age: 0-17 years, 18-64 years. Enrolment: 26.
Start date (EU): 2021-07-12. Decision date: 2024-06-27. Results received: No. Last updated: 2026-05-21.
Decision dates by country: DE: 2024-06-27, IT: 2024-07-29, ES: 2024-06-27

Condition(s): Spinal Muscular Atrophy
Product: SPINRAZA 50 mg, SPINRAZA 28 mg

Primary endpoint: Number of Participants With Adverse Events (AEs) and Serious Adverse Events (SAEs) [ Time Frame: Up to Day 1921 ]., Change from Baseline in Growth Parameters [ Time Frame: Up to Day 1921 ].., Number of Participants With Shifts from Baseline in Clinical Laboratory Parameters [ Time Frame: Up to Day 1921 ], Number of Participants With Shifts from Baseline in Electrocardiogram (ECG) [ Time Frame: Up to Day 1921 ], Number of Participants With Shifts from Baseline in Vital Signs [ Time Frame: Up to Day 1921 ], Change from Baseline in Activated Partial Thromboplastin Time (aPTT) [ Time Frame: Up to Day 1921 ], Change from Baseline in Prothrombin Time (PT) [ Time Frame: Up to Day 1921 ], Change from Baseline in International Normalized Ratio (INR) [ Time Frame: Up to Day 1921 ], Change from Baseline in Urine Total Protein [ Time Frame: Up to Day 1921 ], Change from Baseline in Neurological Examination Outcomes for Participants ≤2 Years of Age [ Time Frame: Up to Day 1921]., Number of Participants with Change from Baseline in Neurological Examination Outcomes for Participants >2 Years of Age [ Time Frame: Up to Day 1921 ]., Percentage of Participants With A Postbaseline Platelet Count Below the Lower Limit of Normal on at least 2 Consecutive Measurements [ Time Frame: Up to Day 1921 ], Percentage of Participants With a Postbaseline Corrected QT Interval Using Fridericia's Formula (QTcF) of >500 millisecond (msec) and an Increase from Baseline to Any Postbaseline Timepoint in QTcF of >60 msec [ Time Frame: Up toDay 1921 ]
Endpoint(s): Total Number of New World Health Organization (WHO) Motor Milestones [ Time Frame: Up to Day 1921], Number of Participants Who Used Respiratory Support, by Type [ Time Frame: Up to Day 1921 ], Number of Hours Per Day of Respiratory Support [ Time Frame: Up to Day 1921 ], Number of Days That Respiratory Support Is Used [ Time Frame: Up to Day 1921 ], Time to Death (Overall Survival) [ Time Frame: Up to Day 1921 ], Change from Baseline in Children's Hospital of Philadelphia Infant Test of Neuromuscular Disorders (CHOP INTEND) Total Score [ Time Frame: Up to Day 1921 ]., Change from Baseline in Hammersmith Infant Neurological Examination (HINE) Section 2 Motor Milestones [ Time Frame: Up to Day 1921 ]., Percentage of HINE Section 2 Motor Milestone Responders [ Time Frame: Up to Day 1921 ]., Percentage of Time Spent on Ventilation [ Time Frame: Up to Day 1921 ]., Time to Death or Permanent Ventilation [ Time Frame: Up to Day 1921 ]., Change from Baseline in Hammersmith Functional Motor Scale - Expanded (HFMSE) Score [ Time Frame: Up to Day 1921 ]., Change from Baseline in Revised Upper Limb Module (RULM) Score [ Time Frame: Up to Day 1921 ].., Change From Baseline in Plasma Levels of Neurofilament (NF) [ Time Frame: Up to Day 1921 ]

Source: https://euclinicaltrials.eu/ctis-public/view/2023-505637-27-00